EU clinical trial 2023-506094-35-00: A study to determine the safe dose of iberdomide (CC-220) in combination with R-CHOP21 and CC-98282 in combination with R-CHOP21 in subjects with untreated aggressive B-cell lymphoma
Protocol code: CC-220-DLBCL-001
Sponsor: Celgene Corp. (Pharmaceutical company). Phase: Human Pharmacology (Phase I)- Other. Countries: Spain (ongoing, recruitment ended), Greece (temporarily halted), Poland (temporarily halted).
Therapeutic area(s): Diseases [C] - Hemic and Lymphatic Diseases [C15]
Gender: Female, Male. Age: 18-64 years. Enrolment: 112.
Start date (EU): 2021-09-17. Decision date: 2023-09-15. Results received: No. Last updated: 2026-07-13.
Decision dates by country: PL: 2023-12-06, GR: 2023-10-30, ES: 2023-09-15

Condition(s): Newly diagnosed aggressive B-cell lymphoma (a-BCL)

Source: https://euclinicaltrials.eu/ctis-public/view/2023-506094-35-00